EU clinical trial 2023-504089-43-00: A trial to learn how much budesonide, glycopyrronium, and formoterol fumarate (BGF) gets into and moves throughout the body when it is taken with hydrofluoroolefin (HFO) compared to when it is taken with hydrofluoroalkane (HFA) in healthy adults
Protocol code: D5985C00008
Sponsor: AstraZeneca AB (Pharmaceutical company). Phase: Human Pharmacology (Phase I)- Other. Countries: Germany (ended).
Therapeutic area(s): Not possible to specify
Gender: Female, Male. Age: 18-64 years. Enrolment: 42.
Status: Ended. Start date (EU): 2024-03-14. End date (EU): 2024-06-11. Decision date: 2024-03-11. Results received: No. Last updated: 2024-04-25.
Decision dates by country: DE: 2024-04-25

Condition(s): Not applicable, healthy volunteers

Source: https://euclinicaltrials.eu/ctis-public/view/2023-504089-43-00